EU clinical trial 2024-518174-13-00: A Prospective, randomized, single blind, multicenter Phase III study on organ preservation with Custodiol-N solution compared with Custodiol solution in liver transplantation
Protocol code: CLN-LTX-III/08ESP/19
Sponsor: Dr. Franz Koehler Chemie GmbH (Pharmaceutical company). Phase: Therapeutic confirmatory (Phase III). Countries: Spain (ongoing, recruitment ended).
Therapeutic area(s): Not possible to specify
Gender: Female, Male. Age: 18-64 years, 65+ years. Enrolment: 200.
Status: Ongoing, recruitment ended. Start date (EU): 2024-10-24. Decision date: 2024-10-24. Results received: No. Last updated: 2025-12-22.

Condition(s): Liver transplantation
Product: Custodiol-N, Custodiol solución para cardioplejía y para conservación de órganos

Primary endpoint: Area under the curve (AUC) GPT (ALT) after transplantation during 7 days: with each liver transplant patient enrolled in the study, GPT will be measured once per day during the first 7 days, according to the standard practice of the center laboratory. Area under the curve will be analysed for this variable comparing Custodiol and Custodiol-N groups
Endpoint(s): Absolute peak LDH within 7 days after transplantation: the highest peak of lactate-dehydrogenase within 7 days after transplantation according to the practice of the site laboratory, Olthoff criteria: bilirubin, international normalized ratio of prothrombin (INR). The Olthoff criteria will be applied to evaluate initial poor function when one or more of the following parameters would be present: Bilirubin ≥ 10 mg/dl on Day 7 after the surgery; INR ≥ 1.6 on Day 7 after the surgery; Alanine aminotransferase (ALT) or aspartate aminotransferase (AST) > 2000 IU/L within the first 7 days after the surgery, MEAF score (Model for early allograft dysfunction), Evaluation of the moment (day) of peak GPT and peak LDH: the highest daily peak GPT and peak LDH will be evaluated for comparisons between groups, Evaluation of the serum bilirubin, GOT, GPT, LDH, total albumin and PT at 3 months and 6 months: these parameters will be measured at 3 months and 6 months after liver transplantation according to the references values of the site laboratory, Number of episodes of cholestasis, Therapy for cholangitis, Episodes of biliary leakage and intrahepatic and/or extrahepatic biliary strictures, Comparison in Extended Criteria Donors: the influence of Custodiol-N in liver transplants with ECD and DCD donors will be compared. ECD donors are defined as high risk donors with a donor risk index (DRI) higher than 1.7, Comparison in DCD donors: DCD donors are defined as donation after circulatory death donors and will be compared in liver transplants with Custodiol and Custodiol-N

Source: https://euclinicaltrials.eu/ctis-public/view/2024-518174-13-00